EU clinical trial 2024-517403-36-00: Evolution of the cardiac function during the follow-up of the anticancer immunotherapy inhibiting PD-1. IMMUNOCARD
Sponsor: Centre Hospitalier Regional De Marseille (Hospital/Clinic/Other health care facility). Phase: Therapeutic use (Phase IV). Countries: France (ongoing, recruiting).
Therapeutic area(s): Diseases [C] - Neoplasms [C04]
Gender: Female, Male. Age: 18-64 years, 65+ years. Enrolment: 50.
Status: Ongoing, recruiting. Start date (EU): 2018-04-09. Decision date: 2024-10-07. Results received: No. Last updated: 2026-04-01.

Condition(s): Cancer
Product: PEMBROLIZUMAB, NIVOLUMAB

Primary endpoint: Evolution of left ventricular function measured by the global longitudinal strain value.

Source: https://euclinicaltrials.eu/ctis-public/view/2024-517403-36-00